EU clinical trial 2023-507654-33-00: MB-CART19.1 in refractory SLE
Protocol code: M-2022-398
Sponsor: Miltenyi Biomedicine GmbH (Pharmaceutical company). Phase: Phase I and Phase II (Integrated)- Other. Countries: Germany (ongoing, recruiting).
Therapeutic area(s): Diseases [C] - Immune System Diseases [C20]; Diseases [C] - Skin and Connective Tissue Diseases [C17]
Gender: Female, Male. Age: 18-64 years, 65+ years. Enrolment: 30.
Status: Ongoing, recruiting. Start date (EU): 2024-08-12. Decision date: 2023-10-23. Results received: No. Last updated: 2026-03-25.

Condition(s): Refractory systemic lupus erythematosus (SLE)

Source: https://euclinicaltrials.eu/ctis-public/view/2023-507654-33-00